EU clinical trial 2022-501622-37-00: A Double-blind, Randomized, Active-controlled, Parallel-group, Phase 1/3 study to Compare Efficacy, Pharmacokinetics, Pharmacodynamics and Safety of CT-P53 and Ocrevus in Patients with Relapsing-remitting Multiple Sclerosis.
Protocol code: CT-P53 3.1
Sponsor: Celltrion Inc. (Pharmaceutical company). Phase: Therapeutic confirmatory (Phase III). Countries: Romania (ongoing, recruitment ended), Poland (ongoing, recruitment ended), Croatia (ongoing, recruitment ended), Bulgaria (ongoing, recruitment ended), Czechia (ongoing, recruitment ended), Spain (ongoing, recruitment ended).
Therapeutic area(s): Diseases [C] - Nervous System Diseases [C10]
Gender: Female, Male. Age: 18-64 years. Enrolment: 333.
Status: Ongoing, recruitment ended. Start date (EU): 2024-01-16. Decision date: 2023-10-16. Results received: No. Last updated: 2026-06-02.
Decision dates by country: HR: 2023-11-20, PL: 2023-11-10, BG: 2023-11-20, RO: 2023-10-16, CZ: 2024-07-01, ES: 2024-07-01

Condition(s): Multiple Sclerosis
Product: Solu-Medrone powder and solvent for solution for injection or concentrate for solution for infusion 125 mg/vial., Ocrevus 300 mg concentrate for solution for infusion, Zirtek 1 mg/ml oral solution, OCRELIZUMAB, Paracetamol 500 mg HEXAL bei Fieber und Schmerzen, 500 mg Tabletten, CT-P53

Primary endpoint: For PK Group: Area under the concentration-time curve from time zero to Week 2 (AUC0-wk2), For PK Group: Area under the concentration-time curve from Week 2 to Week 24 (AUCwk2-wk24), For Main Study Group: Total number of new GdE lesions on T1-weighted brain MRI up to Week 48

Source: https://euclinicaltrials.eu/ctis-public/view/2022-501622-37-00